EU clinical trial 2023-503671-16-00: Effect of vitamin D3 supplementation in participants with periodontitis and vitamin D deficiency: A randomized, interventional, parallel, placebo-controlled, double blind clinical trial.
Protocol code: D-CURE-IV-22-1
Sponsor: Laboratoires S.M.B. (Pharmaceutical company). Phase: Therapeutic use (Phase IV). Countries: Belgium (ongoing, recruitment ended).
Therapeutic area(s): Diseases [C] - Stomatognathic Diseases [C07]
Gender: Female, Male. Age: 18-64 years, 65+ years. Enrolment: 82.
Status: Ongoing, recruitment ended. Start date (EU): 2023-12-15. Decision date: 2023-12-05. Results received: No. Last updated: 2025-08-26.

Condition(s): Periodontitis
Product: D-CURE 25000 UI gélules., Placebo of vitamin D

Primary endpoint: Absolute change from baseline (V2) to week 24 (V4) in the number of residual PPD ≥ 5mm.
Endpoint(s): Absolute change from baseline (V2) to week 12 (V3) and 24 (V4) on the mean probing pocket depth (PPD)., Absolute change from baseline (V2) to week 12 (V3) and 24 (V4) on the mean clinical attachment level (CAL)., Absolute change from baseline (V2) to week 12 (V3) and week 24 (V4) in the number of residual PPD ≥ 4mm, Absolute change from baseline (V2) to week 12 (V3) in the number of residual PPD ≥ 5mm., Absolute change from baseline (V2) to week 12 (V3) and week 24 (V4) in the number of residual PPD ≥ 6mm, Absolute change from baseline (V2) to week 12 (V3) and 24 (V4) on the bleeding on probing (BoP), Absolute change from baseline to week 12 (V3) and 24 (V4) on the plaque control (O’Leary), Percentage of participants with ≤4 sites with PPD ≥ 5mm at week 24 (V4), Absolute change from baseline (V1) to week 12 (V3) and 24 (V4) in the 25(OH)D3 serum concentration., Percentage of participants reaching 25(OH)D3 serum concentrations superior to 30 ng/ml at week 24 (V4)., Incidence in adverse events including adverse events (AEs), serious adverse events (SAEs), and suspected unexpected serious adverse reactions (SUSARs)., Change from baseline in laboratory data including the assessment of serum concentration of calcium and phosphate throughout the clinical trial.

Source: https://euclinicaltrials.eu/ctis-public/view/2023-503671-16-00